EU clinical trial 2023-507895-36-00: A 12-Month, Randomized, Controlled, Open-Label, Dose Escalation Study Evaluating Safety, Tolerability, Pharmacokinetics (PK) and Pharmacodynamics (PD) of an Anti-CD2 Monoclonal Antibody, TCD601(siplizumab) Compared to Anti-Thymocyte Globulin (rATG), as Induction Therapy in de novo Renal Transplant Recipients
Protocol code: TCD601B101
Sponsor: Itb-Med AB (Pharmaceutical company). Phase: Therapeutic exploratory (Phase II). Countries: Sweden (ended), Spain (ended), Austria (ended).
Therapeutic area(s): Phenomena and Processes [G] - Immune system processes [G12]
Gender: Female, Male. Age: 18-64 years, 65+ years. Enrolment: 33.
Status: Ended. Start date (EU): 2021-06-06. End date (EU): 2024-12-11. End date: 2024-12-12. Decision date: 2024-02-07. Results received: Yes. Last updated: 2024-08-02.
Decision dates by country: ES: 2024-02-07, AT: 2024-02-12, SE: 2024-02-07

Condition(s): Renal Transplantation
Product: Cetirizina Mylan 10 mg comprimidos revestidos por película, Prednisolone 5mg Soluble Tablets, THYMOGLOBULINE 5 mg/ml, poeder voor oplossing voor infusie, Thymoglobuline, pulver til infusionsvæske, opløsning, Adport 0,5 mg, capsules, hard, CellCept 250 mg capsules, Thymoglobuline 5 mg/ml, Pulver zur Herstellung einer Infusionslösung., Paracetamol 500 mg Film Coated Tablets

Primary endpoint: Adverse events (AEs), Serious adverse events (SAEs), Clinically significant changes in clinical chemistry, hematology, vital signs, serology, Siplizumab PK, Immunophenotyping, CD2 receptor occupancy (RO), Estimated glomerular filtration rate (eGFR) via Modification of Diet in Renal Disease (MDRD) equation., Anti-siplizumab antibodies
Endpoint(s): Immunophenotyping via fluorescence-activated cell sorting (FACS)., Lymphocyte counts, CD2 RO, Incidence of tBPAR, de novo-DSA / anti-human leukocyte antigen (HLA) antibody measurement, Incidence of AMR, eGFR

Source: https://euclinicaltrials.eu/ctis-public/view/2023-507895-36-00